EU clinical trial 2025-522562-70-00: A single-dose, open-label, randomized, two-period, two-sequence, crossover pivotal bioequivalence study on 400 mg / 5 mL amoxicillin + 57 mg / 5 mL of clavulanic acid powder for oral suspension in healthy volunteers under fed conditions.
Sponsor: Tarchominskie Zaklady Farmaceutyczne Polfa S.A. (Pharmaceutical company). Phase: Human Pharmacology (Phase I)- Bioequivalence Study. Countries: Czechia (ended).
Therapeutic area(s): Diseases [C] - Bacterial Infections and Mycoses [C01]
Gender: Female, Male. Age: 18-64 years. Enrolment: 56.
Status: Ended. Start date (EU): 2025-09-08. End date (EU): 2025-12-17. Decision date: 2025-08-26. Results received: No. Last updated: 2025-08-26.

Condition(s): infection

Source: https://euclinicaltrials.eu/ctis-public/view/2025-522562-70-00